EU clinical trial 2024-514975-16-00: A Phase 2b Pivotal Study to Evaluate the Efficacy and Safety of Izokibep in Subjects with Non-infectious, Intermediate-, Posterior- or Pan-uveitis
Protocol code: 21103
Sponsor: Acelyrin Inc. (Pharmaceutical company). Phase: Therapeutic exploratory (Phase II). Countries: France (ended), Czechia (ended), Austria (ended), Spain (ended), Germany (ended), Italy (ended).
Therapeutic area(s): Diseases [C] - Eye Diseases [C11]
Gender: Female, Male. Age: 18-64 years, 65+ years. Enrolment: 21.
Status: Ended. Start date (EU): 2022-12-22. End date (EU): 2025-01-07. End date: 2025-02-08. Decision date: 2024-08-19. Results received: Yes. Last updated: 2025-02-19.
Decision dates by country: AT: 2024-09-29, CZ: 2024-08-19, FR: 2024-08-20, IT: 2024-09-09, DE: 2024-08-27, ES: 2024-08-20

Condition(s): Non-infectious, Intermediate-, Posterior- or Pan-uveitis
Product: The ABY-035 Formulation Buffer (FB) 10 mM Sodium Phosphate, 150 mM NaCl, and 0.5 mM EDTA at pH 7.0 is intended to be used for parenteral administration as Placebo of izokibep (ABY-035) in clinical trials., Izokibep

Primary endpoint: Time to treatment failure
Endpoint(s): • Quiescence • BCVA • NEI-VFQ-25 score • Central retinal thickness • Central retinal thickness • TEAEs, events of special interest and SAEs • Laboratory values and vital signs at collected timepoints • ADAs"

Source: https://euclinicaltrials.eu/ctis-public/view/2024-514975-16-00